EU clinical trial 2024-516466-11-00: A Phase II Multicentric Study of Olaparib in PALB2-related Advanced Pancreatic Cancer (PALBOLA)
Sponsor: Azienda Ospedaliero Universitaria Di Modena (Hospital/Clinic/Other health care facility). Phase: Therapeutic exploratory (Phase II). Countries: Italy (ongoing, recruiting).
Therapeutic area(s): Diseases [C] - Neoplasms [C04]
Gender: Female, Male. Age: 18-64 years, 65+ years. Enrolment: 16.
Status: Ongoing, recruiting. Start date (EU): 2024-11-12. Decision date: 2024-11-12. Results received: No. Last updated: 2026-01-15.

Condition(s): Locally advanced or metastatic pancreatic neoplasm with pathogenetic (C5) or possibly pathogenetic (C4) mutation of PALB2 found at the somatic or germinal level.
Product: Lynparza 100 mg film-coated tablets, Lynparza 150 mg film-coated tablets

Primary endpoint: Objective response rate (ORR), defined as the percentage of patients with response of either CR or PR.
Endpoint(s): Assessment of PFS (progression-free survival), DOR (duration of response), DCR (disease control rate), OS (overall survival), safety and tolerability of treatment. Furthermore, the quality of life will be assessed through the EORTC QLQ-C30 questionnaire.

Source: https://euclinicaltrials.eu/ctis-public/view/2024-516466-11-00